EU clinical trial 2023-503541-54-00: A study to test how well different doses of BI 1584862 are tolerated by healthy men
Protocol code: 1484-0002
Sponsor: Boehringer Ingelheim International GmbH (Industry). Phase: Human Pharmacology (Phase I)- Other. Countries: Germany (ended).
Therapeutic area(s): Diseases [C] - Eye Diseases [C11]
Gender: Male. Age: 18-64 years. Enrolment: 50.
Status: Ended. Start date (EU): 2023-08-28. End date (EU): 2024-05-05. Decision date: 2023-07-25. Results received: No. Last updated: 2023-07-25.

Condition(s): Healthy volunteer trial

Source: https://euclinicaltrials.eu/ctis-public/view/2023-503541-54-00